EU clinical trial 2024-514899-41-00: PELICAN-IPC 2015-016 A prospective, multicentre, open-label, randomized, Phase II study of Pembrolizumab in combination with neo-adjuvant EC-Paclitaxel regimen in HER2-negative inflammatory Breast Cancer
Protocol code: PELICAN-IPC 2015-016
Sponsor: Institut Paoli Calmettes (Hospital/Clinic/Other health care facility). Phase: Therapeutic exploratory (Phase II). Countries: France (ongoing, recruiting).
Therapeutic area(s): Diseases [C] - Neoplasms [C04]
Gender: Female, Male. Age: 18-64 years, 65+ years. Enrolment: 72.
Status: Ongoing, recruiting. Start date (EU): 2024-10-31. Decision date: 2024-10-31. Results received: No. Last updated: 2024-10-31.

Condition(s): Breast cancer
Product: KEYTRUDA 25 mg/mL concentrate for solution for infusion, ENDOXAN 1000 mg, poudre pour solution injectable, EPIRUBICINE MEDAC 2 mg/ml, solution pour perfusion, PACLITAXEL KABI 6 mg/ml, solution à diluer pour perfusion.

Primary endpoint: Central evaluation of pathological complete response rate as defined as absence of any residual invasive cancer on hematoxylin and eosin evaluation of the resected breast specimen and all sampled ipsilateral lymph nodes following completion of NAST (i.e., ypT0/is, ypN0 in the current AJCC staging system), Dose Limiting Toxicity (DLT) rates as defined as incidence of DLT during the 21 days following the first administration of pembrolizumab in combination with EC, will be assessed in the first 6 patients
Endpoint(s): Occurrence of serious adverse events and adverse events starting grade 2 or grade 1 (run-in period) according to the National Cancer Institute (NCI) Common Terminology Criteria for Ad-verse Events (CTCAE) V5.0, Local evaluation of pathological complete response rate as defined as absence of any residual invasive cancer on hematoxylin and eosin evaluation of the resected breast specimen and all sampled ipsilateral lymph nodes following completion of NAST (i.e., ypT0/is, ypN0 in the current AJCC staging system), Invasive disease-free survival (IDFS), as defined as time from surgery to the first documented occurrence of an event, defined as: Ipsilateral invasive breast tumor recurrence or Ipsilateral local-regional invasive breast cancer recurrence or Distant recurrence or contralateral invasive breast cancer or death from any cause, Event free survival (EFS), defined as time from randomization to disease progression, disease recurrence (local, regional, distant, or contralateral [invasive or non-invasive]), or death from any cause), Overall survival (OS), defined as time from randomization to death from any cause

Source: https://euclinicaltrials.eu/ctis-public/view/2024-514899-41-00